EU clinical trial 2023-507987-38-00: A Multicentre, Randomised, Double-Blind, Parallel-Group, Placebo- Controlled Phase 3 Efficacy and Safety Study of Benralizumab in Patients with Eosinophilic Chronic Rhinosinusitis with Nasal Polyps (ORCHID)
Protocol code: D3252C00002
Sponsor: AstraZeneca AB (Pharmaceutical company). Phase: Therapeutic confirmatory (Phase III). Countries: Italy (ended), Bulgaria (ended), Hungary (ended), Poland (ended), Belgium (ended).
Therapeutic area(s): Diseases [C] - Respiratory Tract Diseases [C08]
Gender: Female, Male. Age: 18-64 years, 65+ years. Enrolment: 79.
Status: Ended. Start date (EU): 2021-10-14. End date (EU): 2024-12-18. End date: 2025-04-07. Decision date: 2024-02-14. Results received: Yes. Last updated: 2025-02-03.
Decision dates by country: BE: 2024-02-14, BG: 2024-03-14, PL: 2024-02-20, IT: 2024-02-19, HU: 2024-02-14

Condition(s): Severe CRSwNP patients with asthma.
Product: Mometasonfuroaat Teva 50 microgram/verstuiving, neusspray, suspensie, Mometasonfuroat-ratiopharm® 50 Mikrogramm/Sprühstoß Nasenspray, Suspension, Placebo for benralizumab for clinical trials is a sterile liquid solution presented in an accessorized prefilled syringe (apfs) for subcutaneous injection., Fasenra 30 mg solution for injection in pre-filled syringe

Primary endpoint: Change form baseline in endoscopic total nasal polyp score (NPS), Change form baseline in mean nasal blockage score(NBS)
Endpoint(s): • Change from baseline in difficulty with sense of smell (DSS) score, • Change from baseline in Lund Mackay score, • Change from baseline in SinoNasal Outcome Test (SNOT-22) score., • Time to first nasal polyp surgery, • Time to first SCS course for NP, • Change from baseline in nasal symptom score(s), Time to first NP surgery and/or SCS use for CRSwNP., Proportion of patients with NP surgery and/or SCS use for CRSwNP.

Source: https://euclinicaltrials.eu/ctis-public/view/2023-507987-38-00